EU clinical trial 2023-504079-26-01: NEFARTHRO - Effets précoces et tardifs du néfopam dans l'analgésie multimodale après arthroplastie totale de hanche
Protocol code: NEFARTHRO
Sponsor: Centre Hospitalier Regional Universitaire De Tours (Hospital/Clinic/Other health care facility). Phase: Therapeutic confirmatory (Phase III). Countries: France (ongoing, recruiting).
Therapeutic area(s): Diseases [C] - Pathological Conditions, Signs and Symptoms [C23]
Gender: Female, Male. Age: 18-64 years, 65+ years. Enrolment: 546.
Status: Ongoing, recruiting. Start date (EU): 2025-02-10. Decision date: 2023-08-23. Results received: No. Last updated: 2025-08-06.

Condition(s): Arthroplastie totale de hanche
Product: ACUPAN 20 mg/2 mL, solution injectable, CHLORURE DE SODIUM 0,9 % BAXTER, solution pour perfusion en poche

Primary endpoint: Consommation de morphine cumulée entre la fin de l'intervention (J0 – H0) et dans les 24 heures suivant l’intervention exprimée en mg de morphine IV incluant la titration en Salle de Surveillance Post-Interventionnelle (SSPI)
Endpoint(s): Douleurs auto-évaluées maximum par l’Echelle numérique simplifiée (ENS) allant de 0 (absence de douleur) à 10 (douleur maximale) au repos en SSPI, au repos et à la marche entre la sortie de SSPI et H24, à H24, et le jour de la sortie,, Récupération fonctionnelle précoce : délai de reprise de la marche, de sortie de chambre, de montée des escaliers, durée de séjour (Questionnaire standardisé par un investigateur à H24 et J5 ou sortie) (19) et effets de l'analgésie sur la récupération fonctionnelle tardive : délai d’abandon des cannes/béquilles. (Questionnaire standardisé téléphonique à 6 mois, (19))., Consommation d’antalgique morphinique à l’hôpital entre le 1er et le 5ème jour ou la sortie (questionnaire standardisé par un investigateur à H24 et J5 ou à la sortie)., Douleurs chroniques à 6 mois (au repos et à la marche) à l’aide d’un questionnaire standardisé par téléphone., Douleurs neuropathiques précoces et tardives : score de douleurs neuropathiques (score standardisé DN2, une version simplifiée du DN4) à H24 et à 6 mois, Profil de sécurité du néfopam avec le recueil de tous les EvI graves (notamment convulsions nécessitant au moins une dose d’anticonvulsivant, état confusionnel ou hallucinations aiguës mentionnées dans le dossier médical ou paramédical du patient ou rapporté par le patient à J5, anaphylaxie grade II ou supérieure pendant l’administration, recours à des antispasmodiques urinaires ou à des sondages urétraux / cathéter sus pubien, …) au cours du suivi du patient et des EvI non graves, Effets indésirables de la morphine (H24 et J5 max ou sortie, (19)) : survenue de nausées et/ou vomissements, recours à un anti-nauséeux, prurit nécessitant une modification de la prise en charge, rétention d'urines, recours à des antispasmodiques urinaires ou à des sondages urétraux / cathéter sus pubien, ou somnolence anormale (chaque paramètre étant analysé séparément)., Impact économique de la généralisation de la stratégie recommandée suite aux résultats de l'étude clinique, par années et par années cumulées sur les 5 ans de l'horizon temporel, selon le point de vue de l'Assurance Maladie et de l’hôpital.

Source: https://euclinicaltrials.eu/ctis-public/view/2023-504079-26-01